EU clinical trial 2023-507801-32-00: Clinical Surveillance vs. Anticoagulation for Low-risk Patients with Isolated Subsegmental Pulmonary Embolism: A Multicenter Randomized Placebo-Controlled Non-Inferiority Trial
Protocol code: SAFE-SSPE
Sponsor: Insel Gruppe AG (Hospital/Clinic/Other health care facility). Phase: Therapeutic use (Phase IV). Countries: Netherlands (ongoing, recruiting), France (ongoing, recruiting), Belgium (ongoing, recruiting).
Therapeutic area(s): Diseases [C] - Cardiovascular Diseases [C14]
Gender: Female, Male. Age: 18-64 years, 65+ years. Enrolment: 76.
Status: Ongoing, recruiting. Start date (EU): 2026-04-22. Decision date: 2023-10-27. Results received: No. Last updated: 2026-07-17.
Decision dates by country: BE: 2024-08-26, FR: 2023-11-03, NL: 2023-10-27

Condition(s): Isolated Subsegmental Pulmonary Embolism
Product: Rivaroxaban Bayer, RIVAROXABAN, Rivaroxaban Bayer, RIVAROXABAN, Placebo for BAY 597939, Hard gelatine capsule filled with maize starch

Primary endpoint: The primary outcome will be the proportion of recurrent, clinically symptomatic, objectively confirmed VTE within 90 days of randomization, defined as recurrent fatal or nonfatal pulmonary embolism (PE) or lower limb deep vein thrombosis (DVT; efficacy).
Endpoint(s): The secondary outcomes will be the proportion of clinically significant bleeding and all-cause mortality at 90 days of randomization (safety)., The ancillary outcomes will be health-related quality of life, functional status, and medical resource utilization at 90 days of randomization.

Source: https://euclinicaltrials.eu/ctis-public/view/2023-507801-32-00